EU clinical trial 2024-516261-36-00: A Phase I trial to investigate the pharmacokinetics and ECG effects of single doses of linaprazan glurate administered as oral tablets to healthy participants
Protocol code: CX842A2104
Sponsor: Cinclus Pharma Holding AB (publ) (Pharmaceutical company). Phase: Human Pharmacology (Phase I)- Other. Countries: Sweden (authorised, recruitment pending).
Therapeutic area(s): Diseases [C] - Digestive System Diseases [C06]
Gender: Female, Male. Age: 18-64 years, 65+ years. Enrolment: 129.
Status: Authorised, recruitment pending. Decision date: 2024-08-16. Results received: No. Last updated: 2026-03-16.

Condition(s): Erosive Gastroesophageal Reflux Disease (eGERD)

Source: https://euclinicaltrials.eu/ctis-public/view/2024-516261-36-00